EU clinical trial 2024-516407-16-00: Rapid rEcognition of COrticosteroid Resistant or sentive Sepsis - RECORDS; A Multicentre Concealed‐Allocation Multi-arms Blinded Randomized Controlled Trial to Identify the Best Sepsis Population for Corticotherapy
Protocol code: APHP191110
Sponsor: Assistance Publique Hopitaux De Paris (Hospital/Clinic/Other health care facility). Phase: Therapeutic confirmatory (Phase III). Countries: France (ended).
Therapeutic area(s): Diseases [C] - Bacterial Infections and Mycoses [C01]
Gender: Female, Male. Age: 18-64 years, 65+ years. Enrolment: 1800.
Status: Ended. Start date (EU): 2020-04-10. End date (EU): 2025-11-28. Decision date: 2024-11-05. Results received: No. Last updated: 2026-02-05.

Condition(s): Patients admitted to the ICU proven or suspected infection as the main diagnosis.
Product: BETAMETHASONE, Placebo of fludrocortisone, HYDROCORTISONE HEMISUCCINATE, Placebo of hydrocortisone, FLUDROCORTISONE

Primary endpoint: 90-Day organ dysfunction, ventilation and vasopressors free survival after randomization, which is a composite of day 90 mortality and survival free days off vasopressors and mechanical ventilation, and with SOFA score > 6
Endpoint(s): Mortality at 7, 14, 28 day and 6 months., Vasopressor free days: defined as the number of days with permanent hemodynamic stability in the absence of any vasopressor agent, norepinephrine, phenylephrine, epinephrine, dopamine, vasopressine or its analogs, and soever. When a patient will die on vasopressor therapy, the corresponding vasopressor free day will be 0., Mechanical ventilation free days: defined as the number of days with permanent appropriate oxygenation while the patients is extubated and breathing spontaneously, i.e. no need for non invasive ventilation, high flow oxygen or CPAP. Other uses of non-invasive ventilation are not counted. When a patient will die on mechanical ventilation or will be discharge home on mechanical ventilation, the corresponding mechanical ventilation free day will be 0., Organ dysfunction free days: Organ function (including renal function) will be assessed by the SOFA score (Vincent 1996). Organ dysfunction will be defined by a SOFA score of > 6 (Annane 2018). Organ dysfunction free days are defined by the number of days with os total SOFA score of 6 or less. When a patient will die on vasopressor therapy, the corresponding vasopressor free day will be 0., HRQoL in 6-month survivors assessed by the EuroQol-5D (EQ-5D)., Proportion of patients with a decision to withhold and/or withdraw active treatments, ICU and hospital length of stay, Rate of re-admission to the ICU during the 180 days after randomization, Safety endpoints: see protocol

Source: https://euclinicaltrials.eu/ctis-public/view/2024-516407-16-00